EU clinical trial 2023-503183-16-00: A randomized, double-blind, placebo-controlled, multicenter study to evaluate the efficacy, safety, tolerability, pharmacokinetics and pharmacodynamics of orally administered GLPG3667 in adult subjects with active systemic lupus erythematosus.
Protocol code: GLPG3667-CL-215
Sponsor: Galapagos (Pharmaceutical company). Phase: Therapeutic exploratory (Phase II). Countries: Germany (ended), France (ended), Spain (ended), Poland (ended), Bulgaria (ended), Hungary (ended).
Therapeutic area(s): Phenomena and Processes [G] - Immune system processes [G12]
Gender: Female, Male. Age: 18-64 years, 65+ years. Enrolment: 70.
Status: Ended. Start date (EU): 2024-01-16. End date (EU): 2026-01-26. End date: 2026-02-27. Decision date: 2023-12-07. Results received: No. Last updated: 2025-02-06.
Decision dates by country: FR: 2023-12-07, HU: 2023-12-11, ES: 2023-12-12, PL: 2023-12-07, BG: 2023-12-08, DE: 2023-12-07

Condition(s): Systemic Lupus Erythematosus
Product: Placebo consists only of excipients which are identical to those in the active GLPG3667 drug product, GLPG3667

Primary endpoint: - Proportion of subjects who achieved the SLE responder index (SRI)-4 response at Week 32.
Endpoint(s): - Proportion of subjects who achieved the SRI-4 response at Week 48., - Proportion of subjects who achieved the British Isles Lupus Assessment Group (BILAG)-based Composite Lupus Assessment (BICLA) response at Week 32 and Week 48, - Proportion of subjects with >=50% reduction in Cutaneous Lupus Erythematosus Disease Area and Severity Index (CLASI)-A score at Week 32 and Week 48 ., - Proportion of subjects who achieve Lupus Low Disease Activity State (LLDAS) at Week 32 and Week 48., - Change from baseline in the 28-joint count for tender, swollen, and tender + swollen (active) joints at Week 32 and Week 48., - Treatment-emergent adverse events (TEAEs), treatment-emergent serious adverse events, and TEAEs leading to treatment discontinuation., - Estimated GLPG3667 maximum plasma concentration, area under the plasma concentration-time curve, and trough plasma concentration at steady-state.

Source: https://euclinicaltrials.eu/ctis-public/view/2023-503183-16-00